EU clinical trial 2023-505141-48-00: A Phase 3, Randomized, Double-Blind, Placebo-Controlled Study Evaluating The Safety And Efficacy Of Efruxifermin in Subjects With Non-Cirrhotic Nonalcoholic Steatohepatitis (NASH)/Metabolic Dysfunction-Associated Steatohepatitis (MASH) And Fibrosis
Protocol code: AK-US-001-0105
Sponsor: Akero Therapeutics Inc. (Pharmaceutical company). Phase: Therapeutic confirmatory (Phase III). Countries: Spain (ongoing, recruiting), Germany (ongoing, recruiting), Italy (ongoing, recruiting), France (ongoing, recruiting), Poland (ongoing, recruiting).
Therapeutic area(s): Diseases [C] - Nutritional and Metabolic Diseases [C18]
Gender: Female, Male. Age: 18-64 years, 65+ years. Enrolment: 244.
Status: Ongoing, recruiting. Start date (EU): 2024-03-07. Decision date: 2023-12-01. Results received: No. Last updated: 2026-01-22.
Decision dates by country: PL: 2023-12-06, IT: 2023-12-04, DE: 2023-12-04, ES: 2023-12-01, FR: 2023-12-06

Condition(s): Fibrosis, Metabolic Dysfunction-Associated Steatohepatitis (MASH), Non Alcoholic Steatohepatitis (NASH)
Product: Efruxifermin, Efruxifermin, Efruxifermin (EFX) Placebo

Primary endpoint: The primary histology endpoint will be the proportion of subjects in Cohort 1 who achieve NASH/MASH resolution (defined as a NAS of 0─1 for inflammation and 0 for ballooning) AND ≥ 1 stage improvement in fibrosis (based on NASH Clinical Research Network [CRN] fibrosis score) at Week 52., The primary clinical outcomes endpoint will be Event-Free Survival (EFS). EFS will be assessed by time from randomization to the first clinical event including evidence of disease progression, liver decompensation events, liver transplantation or eligibility for liver transplantation, and all-cause mortality.
Endpoint(s): Cohort 1 only: Proportion of subjects who achieve NASH/MASH resolution (defined as a NAS of 0─1 for inflammation and 0 for ballooning) and no worsening of fibrosis (based on NASH CRN fibrosis score) at Week 52., Proportion of subjects who achieve ≥ 1 stage improvement in fibrosis (based on NASH CRN fibrosis score) and no worsening of steatohepatitis (defined as no increase in NAS for ballooning, inflammation, or steatosis) at Week 52., Change from baseline in ELF score and components (tissue inhibitor of metalloproteinase-1 [TIMP-1], hyaluronic acid [HA], amino terminal pro-peptide of type 3 procollagen [PIIINP]), pro-peptide of type 3 procollagen (Pro-C3), and liver stiffness assessed by FibroScan®., Change from baseline in ALT, AST, gamma-glutamyl transferase (GGT), and uric acid, Change from baseline total cholesterol, TG, high density lipoprotein cholesterol (HDL-C), non-HDL—C, and low-density lipoprotein cholesterol (LDL-C), Change from baseline in HbA1c and adiponectin, Change from baseline in body weight., Safety and tolerability will be assessed through the reporting of extent of exposure, AEs, and clinical assessments., Immunogenicity will be assessed through the detection and measurement of ADA, including NAb, against EFX.

Source: https://euclinicaltrials.eu/ctis-public/view/2023-505141-48-00